EU clinical trial 2023-510406-41-00: CLEARTOX: Development of an innovative haemodialysis method to improve dialytic clearance of protein-bound uraemic toxins
Protocol code: 69HCL23_0031
Sponsor: Hospices Civils De Lyon (Hospital/Clinic/Other health care facility). Phase: Therapeutic exploratory (Phase II). Countries: France (ongoing, recruiting).
Therapeutic area(s): Analytical, Diagnostic and Therapeutic Techniques and Equipment [E] - Investigative Techniques [E05]; Diseases [C] - Male Urogenital Diseases [C12]; Diseases [C] - Female Urogenital Diseases and Pregnancy Complications [C13]
Gender: Female, Male. Age: 18-64 years, 65+ years. Enrolment: 12.
Status: Ongoing, recruiting. Start date (EU): 2025-09-22. Decision date: 2024-11-12. Results received: No. Last updated: 2026-04-13.

Condition(s): chronic hemodialysis patients (for more than 3 months) with no residual diuresis (<100 mL/day).
Product: CHLORURE DE SODIUM FRESENIUS 0,9 %, solution pour perfusion, MEDIALIPIDE 20 POUR CENT, émulsion pour perfusion

Primary endpoint: Clearance of p-Cresyl sulfate during hemodialysis. Dialysis clearance is defined as follows: Clairance = Qd X (C dialysate/C arterial) Calculated over 240 minutes with Qd corresponding to dialysate flow rate, C dialysate uremic toxin total concentration in dialysate, C arterial uremic toxin total concentration in blood taken from the arterial port of the dialyzer.
Endpoint(s): The fraction of p-CS reduction during the hemodialysis session. The reduction fraction (RF) will be calculated according to the formula: RF (%) = ( Total concentration (t=0 min) - Total concentration (t=240 min ))/Total concentration (t= 0 min) (arterial C), Clearance and reduction fraction (over 240 minutes) of other protein-bound uremic toxins during the hemodialysis session: indoxyl sulfate, hippuric acid, p-cresyl glucuronide, 3-indole acetic acid, uric acid and 3-carboxy-4-methyl-5propyl-furanpro-pionic acid., Tolerance: % of patients with at least one of the following adverse events: nausea, vomiting or headache during the session., Safety: % of patients with one of the following events: triglyceridemia > 4 g/L or 4.6 mmol/L at the end of the session, alteration in liver balance (ALT, ASAT, gamma GT, PAL, total bilirubin) or significant hemolysis during follow-up., Kinetics of plasma concentrations of medium‑chain fatty acids (octanoate and decanoate) during the hemodialysis session (T0, T60, T120, T180, T240)., Free and total concentrations of uremic toxins throughout the hemodialysis session (T0, T15, T30, T45, T60, T90, T120, T180, T240) (arterial concentration)., Total amount of uremic toxins eliminated at the end of the hemodialysis session: mass transfer calculation Tm = R × C_sample × V_sample (R = ratio between the total dialysate flow and the sampled flow, C_sample = concentration sampled at T240, and V_sample = sampled volume). Sample flow rate = total dialysate volume / sampling duration., Clearance of medium‑chain fatty acids (octanoate and decanoate) during the hemodialysis session (T0, T60, T120, T180, T240).

Source: https://euclinicaltrials.eu/ctis-public/view/2023-510406-41-00